EU clinical trial 2024-513096-41-00: HEMolyse and Organ damage imPROvement in sickle cell disease by VoxElotor. An open-label one stage phase II design.HEMOPROVE
Protocol code: APHP200750
Sponsor: Assistance Publique Hopitaux De Paris (Hospital/Clinic/Other health care facility). Phase: Therapeutic exploratory (Phase II). Countries: France (ended).
Therapeutic area(s): Diseases [C] - Hemic and Lymphatic Diseases [C15]
Gender: Female, Male. Age: 18-64 years, 65+ years. Enrolment: 35.
Status: Ended. Start date (EU): 2022-03-24. End date (EU): 2024-12-04. Decision date: 2024-08-12. Results received: Yes. Last updated: 2024-11-08.

Condition(s): sickle cell disease
Product: Oxbryta 500 mg film-coated tablets

Primary endpoint: Improvement of Intravascular hemolysis, as defined by a ≥20% decrease of plasma Hemoglobin (µmol/l) between W0 and W48 weeks
Endpoint(s): Evolution between W0 and W48 weeks in intravascular hemolysis, as measured by absolute and relative (%) changes from baseline in plasma Hemoglobin (µmol/l) and free plasma Heme (µmol/l), Measurement of total hemoglobin mass based on the CO rebreathing technique (g of Hb / kg), or a stable evolution (i.e. decrease ≤ 10%) in patients initially under EPO therapy and who decreased or discontinued EPO during the study period., RBC lifespan by measurement of alveolar CO (in days), Blood volumes by CO rebreathing method (Total Mass of Hemoglobin (g of Hb), Total blood volume (L), RBC mass (g), Plasma Volume (L) ), Blood viscosity, Cerebral perfusion measured by MRI, Cerebral vaso-reactivity measured by transcranial Doppler (Breath holding test) and Near Infra Red Spectroscopy, Cognitive performance measured by MoCA, Improvement in the 6 minutes walk test on : Time spent under Sp02 88 and 90%, Borg Rating of Perceived Exertion (RPE), distance., Renal perfusion and amount of deoxyhemoglobin by MRI and Iron deposits in renal cortex by MRI, Glomerular Filtration Rate measurements, urine concentration capacity (fasting urinary osmolarity), urine albumin/creatinine ratio, Concomitant treatment observation: decrease / interruption of EPO dose, Safety;(VOC, ACS, Priapism) presence/absence of each signs, RBC properties: density, hemoglobin affinity , viscosity, deformability, senescence parameters, HbF/cell measure, Blood lactate concentration during stress test (submaximal cardiopulmonary exercise test) and echocardiography during submaximal cardiopulmonary exercise test, at rest, ∼2 mmol.L-1 (LT1), ∼4 mmol.L-1 and during the recovery phase to evaluate parameters of left ventricular (LV) contractility, cardiac output and diastolic function

Source: https://euclinicaltrials.eu/ctis-public/view/2024-513096-41-00